EU clinical trial 2023-505165-93-00: A Phase 1 Study of JNJ-87801493 in Combination with CD3 T-Cell Engagers
Protocol code: 87801493LYM1001
Sponsor: Janssen - Cilag International (Pharmaceutical company). Phase: Human Pharmacology (Phase I)- First administration to humans. Countries: Spain (ongoing, recruitment ended), Denmark (ongoing, recruitment ended), France (ended).
Therapeutic area(s): Diseases [C] - Neoplasms [C04]
Gender: Female, Male. Age: 18-64 years, 65+ years. Enrolment: 70.
Start date (EU): 2024-03-01. Decision date: 2024-02-19. Results received: No. Last updated: 2026-03-17.
Decision dates by country: FR: 2025-07-17, DK: 2024-02-19, ES: 2024-02-26

Condition(s): Non-Hodgkin Lymphoid Malignancies

Source: https://euclinicaltrials.eu/ctis-public/view/2023-505165-93-00